EU clinical trial 2024-518453-41-00: A Phase I, Open-Label, Randomized, Two-Period, Cross-Over Study in Healthy Subjects to Assess the Influence of a High-Calorie, High-Fat Meal on the Bioavailability of a 40 mg Extended-Release (XR) Deucrictibant Oral Formulation Administered as a Single Dose.
Protocol code: PHA022121-C021
Sponsor: Pharvaris Netherlands B.V. (Pharmaceutical company). Phase: Human Pharmacology (Phase I)- Other. Countries: Hungary (ended).
Therapeutic area(s): Diseases [C] - Skin and Connective Tissue Diseases [C17]; Diseases [C] - Immune System Diseases [C20]; Diseases [C] - Congenital, Hereditary, and Neonatal Diseases and Abnormalities [C16]
Gender: Female, Male. Age: 18-64 years, 65+ years. Enrolment: 18.
Status: Ended. Start date (EU): 2024-12-30. End date (EU): 2025-02-19. Decision date: 2024-11-15. Results received: No. Last updated: 2024-11-15.

Condition(s): Hereditary angioedema (HAE)

Source: https://euclinicaltrials.eu/ctis-public/view/2024-518453-41-00